EU clinical trial 2023-510453-41-00: EORTC 1333-GU: A Randomized multicenter phase III trial comparing enzalutamide vs. a combination of Ra223 and enzalutamide in asymptomatic or mildly symptomatic castration resistant prostate cancer patients metastatic to bone (PEACE III)
Sponsor: European Organisation For Research And Treatment Of Cancer (Patient organisation/association). Phase: Therapeutic confirmatory (Phase III). Countries: Poland (ongoing, recruitment ended), Italy (ongoing, recruitment ended), Spain (ongoing, recruitment ended), Belgium (ongoing, recruitment ended), Ireland (ongoing, recruitment ended), France (ongoing, recruitment ended), Norway (ongoing, recruitment ended), Denmark (ongoing, recruitment ended).
Therapeutic area(s): Diseases [C] - Neoplasms [C04]
Gender: Male. Age: 18-64 years, 65+ years. Enrolment: 255.
Status: Ongoing, recruitment ended. Start date (EU): 2015-10-26. Decision date: 2024-07-10. Results received: No. Last updated: 2024-08-23.
Decision dates by country: BE: 2024-07-16, DK: 2024-07-12, FR: 2024-08-23, IE: 2024-07-10, IT: 2024-07-16, ES: 2024-07-16, NO: 2024-07-12, PL: 2024-08-06

Condition(s): Castration resistant prostate cancer patients metastatic to bone.
Product: Xtandi - 40 mg soft capsules, Xofigo 1100 kBq/mL solution for injection

Primary endpoint: Radiological Progression free survival (rPFS1)
Endpoint(s): Overall survival, Prostate-cancer specific survival, First symptomatic skeletal event (SSE), Time and incidence of first skeletal progression-free survival, Rate of skeletal fractures, Time to next systemic anti-neoplastic therapy, Treatments elected after first disease progression, Second progression-free survival, Safety according to Common Terminology Criteria for Adverse Events, Pain: Brief Pain Inventory (BPI). In this study only pain related to prostate cancer is considered, Time to pain progression (defined as an increase of 2 or more points in the "worst pain in 24 hours" score from baseline observed at 2 consecutive evaluations ≥ 4 weeks apart OR initiation of short or longacting opioid use for pain), Time to opiate use for cancer-related pain, Quality of Life (EQ-5D-5L)

Source: https://euclinicaltrials.eu/ctis-public/view/2023-510453-41-00